EU clinical trial 2024-518477-34-00: Examination of medication-induced skin inflammation models and their use in the study of antibiotic concentration in inflamed, infected, and healthy subcutaneous tissue
Sponsor: Medical University Of Vienna (Educational Institution). Phase: Human Pharmacology (Phase I)- Other. Countries: Austria (ongoing, recruiting).
Therapeutic area(s): Diseases [C] - Bacterial Infections and Mycoses [C01]; Diseases [C] - Skin and Connective Tissue Diseases [C17]
Gender: Female, Male. Age: 18-64 years. Enrolment: 48.
Status: Ongoing, recruiting. Start date (EU): 2021-10-13. Decision date: 2024-12-10. Results received: No. Last updated: 2025-08-11.

Condition(s): Skin inflammation

Source: https://euclinicaltrials.eu/ctis-public/view/2024-518477-34-00